EU clinical trial 2023-505990-34-00: Hyper-CVAD/MA for high-risk aggressive B-cell lymphomas: a single-centre academic phase II trial (HYPERION)
Sponsor: Karolinska University Hospital (Hospital/Clinic/Other health care facility). Phase: Therapeutic exploratory (Phase II). Countries: Sweden (ongoing, recruiting).
Therapeutic area(s): Diseases [C] - Hemic and Lymphatic Diseases [C15]
Gender: Female, Male. Age: 18-64 years. Enrolment: 183.
Status: Ongoing, recruiting. Start date (EU): 2024-11-08. Decision date: 2024-03-08. Results received: No. Last updated: 2024-07-08.

Condition(s): Lymphoma
Product: DOXORUBICIN HYDROCHLORIDE, Methotrexate Ebewe, 100 mg/ml, koncentrat till infusionsvätska, lösning, VINCRISTINE SULFATE, Vepesid 50 mg mjuka kapslar, Prednisolon Pfizer 10 mg tabletter, CYCLOPHOSPHAMIDE, Etoposid Fresenius Kabi 20 mg/ml - koncentrat till infusionsvätska, lösning , MabThera 500 mg concentrate for solution for infusion, Nordimet 15 mg solution for injection in pre-filled pen, Dexametasona Krka 4 mg comprimidos, Cytarabine STADA 100 mg/ml koncentrat till infusionsvätska, lösning

Primary endpoint: Event-free survival (EFS) at 3 years, EFS, Progression-free survival (PFS), Overall survival (OS), Lymphoma-specific survival (LSS), Overall response rate (ORR), Complete response rate (CRR), Response rates after 6 cycles, Response rates at final assessment in trial, Response duration
Endpoint(s): Treatment-related mortality/Non-lymphoma mortality, Time from diagnostic biopsy to start of chemotherapy and to start of steroids., Number and duration of scheduled and unscheduled hospital admissions, Use of IV antibiotics, Total number of hospital days, Time between chemotherapy regimens and total time from starting to ending treatment within trial, Reconstitution of T-cell (cellular and humoral) immunity, Time on sick leave, Long-term cardiac toxicity, Second primary malignancies

Source: https://euclinicaltrials.eu/ctis-public/view/2023-505990-34-00